EU clinical trial 2023-505749-14-00: A Phase 3 Open-Label, Randomized, Controlled, Global Study of Telisotuzumab Vedotin (ABBV-399) Versus Docetaxel in Subjects with Previously Treated c-Met Overexpressing, EGFR Wildtype, Locally Advanced/Metastatic Non-Squamous Non-Small Cell Lung Cancer
Protocol code: M18-868
Sponsor: AbbVie Deutschland GmbH & Co. KG (Pharmaceutical company). Phase: Therapeutic confirmatory (Phase III). Countries: Sweden (ongoing, recruiting), Spain (ongoing, recruiting), Czechia (ongoing, recruiting), Romania (ongoing, recruiting), Denmark (ongoing, recruiting), Netherlands (ongoing, recruiting), Italy (ongoing, recruiting), France (ongoing, recruiting), Slovakia (ended), Bulgaria (ongoing, recruiting), Portugal (ongoing, recruiting), Germany (ongoing, recruiting), Austria (ongoing, recruiting), Belgium (ongoing, recruiting), Poland (ongoing, recruiting), Greece (ongoing, recruiting).
Therapeutic area(s): Diseases [C] - Neoplasms [C04]
Gender: Female, Male. Age: 18-64 years, 65+ years. Enrolment: 222.
Start date (EU): 2022-03-20. Decision date: 2023-11-28. Results received: No. Last updated: 2026-06-24.
Decision dates by country: SK: 2023-11-28, IT: 2023-12-05, BG: 2023-11-30, RO: 2023-12-05, DE: 2023-12-01, AT: 2023-12-11, FR: 2023-11-30, PL: 2024-01-08, CZ: 2023-12-04, DK: 2023-11-29, BE: 2023-12-11, PT: 2023-11-29, GR: 2024-01-24, NL: 2023-11-28, SE: 2023-11-29, ES: 2023-11-30

Condition(s): c-Met overexpressing EGFR wildtype non-squamous non-small cell lung cancer
Product: DOCETAXEL, Telisotuzumab Vedotin

Primary endpoint: The co-primary endpoints are: Progression-Free Survival (PFS) per blinded independent central review (BICR); Overall Survival (OS)
Endpoint(s): Objective Response Rate (ORR) by BICR, Duration of Response (DoR) by BICR, Change from baseline to Week 12 in physical functioning as measured by the physical functioning domain of the EORTC-QLQ-Core 30 (EORTC QLQ-C30)., Change from baseline to Week 12 in quality of life as measured by the global health status/quality of life domain of the EORTC QLQ-C30., PFS per investigator assessment

Source: https://euclinicaltrials.eu/ctis-public/view/2023-505749-14-00